EU clinical trial 2024-517456-35-00: Pharmacodynamics of IMP 08P2002F0 (Fixed dose combination of 0.34% tropicamide and 2.5% phenylephrine hydrochloride, eye drop, Solution) a new ophthalmic mydriatic solution in healthy volunteers.
Protocol code: UP-CLI-2023-01
Sponsor: Unither Pharmaceuticals (Pharmaceutical company). Phase: Phase I and Phase II (Integrated)- Other. Countries: Greece (ended).
Therapeutic area(s): Analytical, Diagnostic and Therapeutic Techniques and Equipment [E] - Diagnosis [E01]; Diseases [C] - Eye Diseases [C11]
Gender: Female, Male. Age: 18-64 years, 65+ years. Enrolment: 20.
Status: Ended. Start date (EU): 2025-10-08. End date (EU): 2026-01-05. Decision date: 2025-06-16. Results received: Yes. Last updated: 2025-06-16.

Condition(s): to obtain pre-operative mydriasis or for diagnostic purposes
Product: SODIUM CHLORIDE, MYDRIASERT, insert ophtalmique, 0.34 % tropicamide/ 2.5 % phenylephrine hydrochloride

Primary endpoint: The primary endpoint is the change in pupil diameter at 60 min from the time of first dose versus baseline, as measured with pupil photographs (central reading)
Endpoint(s): Time to obtain sufficient mydriasis. (Defined as pupil diameter of 7.0 mm), Proportion of eyes achieving pupil diameter of 6.0 mm or greater throughout the 6 hours, at 30 min, at 1 h, at 2 h, Proportion of eyes achieving pupil diameter of 7.0 mm or greater throughout the 6 hours, at 30 min, at 1 h, at 2 h, Time from baseline to maximal pupil dilation, Change in pupil diameter at other timepoints (10 min, 20 min, 30 min, 45 min, 60 min, 1 h 15, 1 h 30, 2 h, 2 h 30, 3 h, 3 h 30, 4 h, 4 h 30, 5 h, 6 h), Pupil size measured at 10 min, 20 min, 30 min, 45 min, 60 min, 1 h 15, 1 h 30, 2 h, 2 h 30, 3 h, 3 h 30, 4 h, 4 h 30, 5 h, 6 h, Distribution of pupil diameters at 10 min, 20 min, 30 min, 45 min, 60 min, 1 h 15, 1 h 30, 2 h, 2 h 30, 3 h, 3 h 30, 4 h, 4 h 30, 5 h, 6 h, Subject discomfort at the following recording times: 10 min, 30 min, 60 min, 2 h, 6 h, Percent of subjects' study eyes with Pupil Diameter Returning to Baseline [Time Frame: throughout the 6 hours, at 3 h, 4 h, 5°h and 6 h], Percentage of subjects' study eyes returning to less than or equal to 0.2 mm from baseline pupil diameter [Time Frame: throughout the 6 hours, at 3 h, 4 h, 5°h and 6 h], Occurrence of Adverse events, Ocular symptoms other than mydriasis

Source: https://euclinicaltrials.eu/ctis-public/view/2024-517456-35-00